EU clinical trial 2023-504741-32-00: A Phase 2b Randomized, Double-blind, Active- and Placebo-controlled, Parallel-group, Multicenter Study to Evaluate the Efficacy and Safety of Induction and Maintenance Combination Therapy with Guselkumab and Golimumab in Participants with Moderately to Severely Active Crohn’s Disease
Protocol code: 78934804CRD2001
Sponsor: Janssen - Cilag International (Pharmaceutical company). Phase: Therapeutic exploratory (Phase II). Countries: France (ongoing, recruitment ended), Poland (ongoing, recruitment ended), Slovenia (ongoing, recruitment ended), Portugal (ongoing, recruitment ended), Sweden (ongoing, recruitment ended), Austria (ongoing, recruitment ended), Denmark (ended), Czechia (ongoing, recruitment ended), Bulgaria (ended), Germany (ongoing, recruitment ended), Belgium (ongoing, recruitment ended), Croatia (ongoing, recruitment ended), Norway (ongoing, recruitment ended), Hungary (ongoing, recruitment ended), Spain (ongoing, recruitment ended), Estonia (ended), Netherlands (ongoing, recruitment ended), Italy (ongoing, recruitment ended), Greece (ongoing, recruitment ended).
Therapeutic area(s): Diseases [C] - Immune System Diseases [C20]
Gender: Female, Male. Age: 18-64 years. Enrolment: 433.
Start date (EU): 2022-11-30. Decision date: 2024-05-22. Results received: No. Last updated: 2026-06-19.
Decision dates by country: BG: 2024-05-23, EE: 2024-05-24, AT: 2024-05-29, CZ: 2024-05-27, PT: 2024-05-22, ES: 2024-05-22, HR: 2024-05-22, PL: 2024-05-27, NO: 2024-05-23, NL: 2024-05-22, BE: 2024-05-29, SI: 2024-05-22, HU: 2024-05-22, GR: 2024-08-01, SE: 2024-05-22, DK: 2024-05-22, IT: 2024-06-18, FR: 2024-06-12, DE: 2024-05-23

Condition(s): Moderately to Severely Active Crohn's Disease
Product: Placebo for Guselkumab, Golimumab and JNJ-78934804, JNJ-78934804, Golimumab, Guselkumab - solution for injection in pre-filled syringe - 100 mg/mL

Primary endpoint: Clinical remission and endoscopic response at Week 48 compared with each monotherapy

Source: https://euclinicaltrials.eu/ctis-public/view/2023-504741-32-00